EU clinical trial 2024-516843-15-00: BEVERLY: A randomized open-label phase 3 trial comparing bevacizumab + erlotinib vs erlotinib alone as first line treatment of patients with EGFR mutated advanced non squamous non small cell lung cancer
Sponsor: IRCCS Istituto Nazionale Tumori Fondazione Pascale (Hospital/Clinic/Other health care facility). Phase: Therapeutic confirmatory (Phase III). Countries: Italy (ongoing, recruitment ended).
Therapeutic area(s): Diseases [C] - Neoplasms [C04]
Gender: Female, Male. Age: 18-64 years. Enrolment: 200.
Status: Ongoing, recruitment ended. Start date (EU): 2015-11-23. Decision date: 2024-11-18. Results received: No. Last updated: 2026-06-10.

Condition(s): Non-squamous Non-small Cell Lung Cancer
Product: BEVACIZUMAB, ERLOTINIB

Primary endpoint: To test whether the combination of bevacizumab and erlotinib can prolong investigator assessed (IA-PFS) and blinded independent centrally-reviewed progression-free survival (BICR-PFS) as compared with erlotinib alone as first-line treatment in patients with NSCLC with activating mutation of EGFR. Note: CT (or other pertinent) scans performed at baseline and during follow-up will be collected and reviewed by an independent central panel of radiologists who will be blinded to the assigned tr
Endpoint(s): • To compare the two arms in terms of o overall survival o quality of life (EORTC C30 + LC13) o centrally reviewed objective response rate (RECIST v.1.1) o investigator assessed objective response rate (RECIST v.1.1) o adverse events (CTCAE 4.03 version) • To test whether an interaction exists between treatment arms and type of EGFR mutation (exon 19del vs exon 21 L858R vs other) • To explore other possible predictive factors and their interaction with treatment arms • To explore pro

Source: https://euclinicaltrials.eu/ctis-public/view/2024-516843-15-00